EU clinical trial 2024-519345-30-00: A Phase 3, Randomized, Double-blind, Placebo-controlled Study of Felzartamab in Adults with IgA Nephropathy (299IG301 / PREVAIL)
Protocol code: 299IG301
Sponsor: Biogen Idec Research Limited (Pharmaceutical company). Phase: Therapeutic confirmatory (Phase III). Countries: Greece (ongoing, recruiting), Portugal (ongoing, recruiting), Spain (ongoing, recruiting), Croatia (ongoing, recruiting), Czechia (ongoing, recruiting), Belgium (ongoing, recruiting), Bulgaria (ongoing, recruiting), Germany (ongoing, recruiting), Italy (ongoing, recruiting), Poland (ongoing, recruiting), France (ongoing, recruiting).
Therapeutic area(s): Diseases [C] - Immune System Diseases [C20]
Gender: Female, Male. Age: 18-64 years, 65+ years. Enrolment: 201.
Status: Ongoing, recruiting. Start date (EU): 2025-11-12. Decision date: 2025-09-23. Results received: No. Last updated: 2026-05-25.
Decision dates by country: PT: 2025-09-23, BE: 2025-09-23, CZ: 2025-09-24, HR: 2025-09-29, PL: 2025-09-27, GR: 2025-09-25, FR: 2025-09-29, DE: 2025-09-24, ES: 2025-10-28, BG: 2025-09-24, IT: 2025-09-23

Condition(s): IgA nephropathy
Product: DESLORATADINE, Felzartamab, 0.9% Saline, FAMOTIDINE, LORATADINE, CETIRIZINE, METHYLPREDNISOLONE, PARACETAMOL, LEVOCETIRIZINE, DIPHENHYDRAMINE, FEXOFENADINE

Primary endpoint: Percent Change From Baseline in Proteinuria as Measured by the Urine Protein: Creatinine Ratio (UPCR)
Endpoint(s): Change From Baseline in Estimated Glomerular Filtration Rate (eGFR) Values Calculated Using the Chronic Kidney Disease Epidemiology (CKD-EPI) Creatinine Equation, Percentage of participants who progressed to Kidney Malfunction. The percentage of participants progressing to kidney malfunction will be reported based on one of the following, 1. ≥ 40% reduction in eGFR sustained for ≥ 30 days; 2. eGFR < 15 mL/min/1.73m2 for ≥ 30 days; 3. Undergoing dialysis for ≥ 30 days; 4. Undergoing kidney transplantation; 5. Died from kidney failure, Percentage of participants requiring rescue therapy, Felzartamab serum concentrations over time, Number of patients with anti-drug antibodies (ADAs) against felzartamab, Percentage of Participants With Treatment Emergent Adverse Event (TEAE) and Treatment Emergent Serious Adverse Event (TESAE), Number of Participants With Clinically Significant Change From Baseline in Vital Signs Abnormalities, Number of Participants With Clinically Significant Change From Baseline in Physical Examination Abnormalities, Percentage of participants Achieving complete response (CR) CR is defined as UPCR value (based on 24-hour urine collection) of <0.5 gram per gram (g/g), a reduction in UPCR of ≥50%, and a stable eGFR (decrease from baseline in eGFR of ≤25%), Change in Baseline in EGFR Values Calculated Using the CKD-EPI Creatinine Equation, Number of Participants With Clinically Significant Change From Baseline in Laboratory Abnormalities, Number of Participants With Clinically Significant Change From Baseline in Electrocardiogram (ECG) Abnormalities

Source: https://euclinicaltrials.eu/ctis-public/view/2024-519345-30-00